EU clinical trial 2022-500535-36-01: A randomized, double-blind, placebo-controlled, multicenter phase III study to evaluate the efficacy and safety of ABX464 once daily for induction treatment in subjects with moderately to severely active ulcerative colitis
Protocol code: ABX464-105
Sponsor: Abivax (Pharmaceutical company). Phase: Therapeutic confirmatory (Phase III). Countries: France (ended), Spain (ended), Germany (ended), Italy (ended), Poland (ended), Belgium (ended), Austria (ended), Bulgaria (ended), Czechia (ended), Greece (ended), Hungary (ended), Portugal (ended), Netherlands (ended).
Therapeutic area(s): Diseases [C] - Digestive System Diseases [C06]
Gender: Female, Male. Age: 18-64 years, 65+ years. Enrolment: 258.
Status: Ended. Start date (EU): 2023-06-12. End date (EU): 2025-06-25. End date: 2025-06-25. Decision date: 2023-05-22. Results received: Yes. Last updated: 2025-08-13.
Decision dates by country: NL: 2023-09-01, PL: 2023-05-29, AT: 2023-09-04, IT: 2023-05-24, DE: 2023-05-30, ES: 2023-05-29, GR: 2023-08-30, FR: 2023-05-25, PT: 2023-08-17, CZ: 2023-09-06, HU: 2023-09-12, BG: 2023-08-07, BE: 2023-05-22

Condition(s): Moderately to severely active ulcerative colitis
Product: ABX464, The placebo for the 25 and 50 mg ABX464 hard capsules., ABX464

Primary endpoint: Co-primary endpoints: Proportion of subjects who achieve endoscopic improvement at week 8 and proportion of subjects with symptomatic remission at week 8.
Endpoint(s): Proportion of subjects who achieve clinical remission at week 8., Proportion of subjects with clinical response at week 8., Proportion of subjects with HEMI per Geboes scoring at week 8., Incidence of all treatment-emergent adverse events (TEAEs), causally related TEAEs, all serious TEAEs and causally-related serious TEAEs classified by severity., Incidence of TEAEs leading to investigational medicinal product (IMP) discontinuation and study discontinuation., Incidence of treatment-emergent adverse events of special interest (AESIs)., Incidence of clinically significant laboratory abnormalities., Incidence of clinically significant abnormalities regarding vital signs and electrocardiograms (ECGs)

Source: https://euclinicaltrials.eu/ctis-public/view/2022-500535-36-01